EU clinical trial 2024-510972-19-00: Axicabtagene Ciloleucel CAR T-Cells in Patients with relapsed or refractory primary mediastinal B-Cell Lymphoma
Protocol code: UniMS23_0018
Sponsor: Universitaet Muenster (Educational Institution). Phase: Therapeutic exploratory (Phase II). Countries: Germany (ended).
Therapeutic area(s): Diseases [C] - Immune System Diseases [C20]
Gender: Female, Male. Age: 18-64 years. Enrolment: 40.
Status: Ended. Start date (EU): 2025-03-13. End date (EU): 2025-07-25. Decision date: 2025-02-07. Results received: Yes. Last updated: 2025-06-16.

Condition(s): Primary mediastinal large B-cell lymphoma (PMBCL)
Product: YESCARTA 0.4 – 2 x 10e8 cells dispersion for infusion

Primary endpoint: CMR rate at 3 months from axicabtagene ciloleucel infusion based on disease assessment by PET-CT or PET-MRI according to Deauville and Lugano Classification

Source: https://euclinicaltrials.eu/ctis-public/view/2024-510972-19-00